EU clinical trial 2024-513406-59-00: PRO_RSTAP study: Effect of medial transversus abdominis plane (TAP) block and rectus sheath block on inguinal hernia surgery recovery, a prospective randomized double-blind study
Sponsor: Pirkanmaan hyvinvointialue (Hospital/Clinic/Other health care facility). Phase: Therapeutic confirmatory (Phase III). Countries: Finland (ongoing, recruiting).
Therapeutic area(s): Diseases [C] - Digestive System Diseases [C06]
Gender: Female, Male. Age: 18-64 years, 65+ years. Enrolment: 200.
Status: Ongoing, recruiting. Start date (EU): 2025-02-05. Decision date: 2024-11-05. Results received: No. Last updated: 2024-11-06.
Decision dates by country: FI: 2024-11-06

Condition(s): Inguinal hernia open surgery recovery
Product: Ropivacaine hydrochloride Kabi 7,5 mg/ml injekcinis tirpalas, Natriumchloride 0,9% Fresenius Kabi oplossing voor infusie, NaCl 0.9 solution

Primary endpoint: Equivalent morphine consumption in the perioperative period and after surgery, divided in: Intraoperative period, the immediate postoperative period, defined as the time between discharge from the operating room and discharge from the hospital and seven postoperative days
Endpoint(s): postoperative pain, as defined by numerical rating scale (NRS), patient opinion of the efficacy of the pain treatment, postoperative nausea and vomiting (PONV), as defined as use of postoperative nausea medications, use of rescue analgesia, rescue hospitalization, intra- and postoperative durations, intraoperative anesthetic methods, analysis of patient flow and, anesthesiologic and surgical complications, depression and anxiety as measured by BDI and STAI queries

Source: https://euclinicaltrials.eu/ctis-public/view/2024-513406-59-00